EU clinical trial 2024-517279-20-02: Levosimendan in Cardiac Arrest: A Randomized Double-blinded Clinical Phase II Trial (LeICA)
Sponsor: Karolinska University Hospital (Hospital/Clinic/Other health care facility). Phase: Therapeutic exploratory (Phase II). Countries: Sweden (ongoing, recruiting).
Therapeutic area(s): Diseases [C] - Cardiovascular Diseases [C14]
Gender: Female, Male. Age: 18-64 years, 65+ years. Enrolment: 40.
Status: Ongoing, recruiting. Start date (EU): 2026-04-14. Decision date: 2025-06-11. Results received: No. Last updated: 2025-06-11.

Condition(s): Cardiac arrest
Product: Glukos 5%, Simdax 2,5 mg/ml koncentrat till infusionsvätska, lösning

Primary endpoint: Survival at day 30 (binary)
Endpoint(s): Conversion to potentially perfusing rhythm (except VT) among patients without potentially perfusing rhythm at study start (binary)., Any ROSC (i.e. return of spontaneous pulse or blood pressure as determined by the treating clinician) (binary)., Transport to hospital (binary)., Survived event (i.e. ROSC sustained until arrival at the emergency department and transfer of care to medical staff at the receiving hospital) (binary), Sustained ROSC (i.e. ≥20 min of uninterrupted spontaneous pulse or blood pressure as determined by the treating clinician) (binary), Time to sustained ROSC (continuous, numerical), Hospital arrival status (i.e. subject’s condition at hospital arrival; ROSC, CPR in progress, deceased) (categorical), Number and duration of vasopressor infusions (duration >1 h) in the ICU up to 72 hours (e.g. norepinephrine, epinephrine, phenylephrine, vasopressin, dopamine, methylene blue), Number and duration of inotrope infusions (duration >1 h) in the ICU up to 72 hours (e.g. epinephrine, dobutamine, milrinone, levosimendan), Mechanical circulatory support in the ICU within 7 days (e.g. veno-arterial extracorporeal membrane oxygenation [VA-ECMO], Impella® device, intra-aortic balloon pump) (binary), Organ dysfunction (e.g. renal, hepatic, cardiac) (exploratory), Neurological outcome at discharge (i.e. cerebral performance category) (1–2 or 3–5) (binary), Circumstances of death (categorical), Plasma concentration of levosimendan (intervention group); undetectable plasma concentration of levosimendan (control group) (during initial 72 hours in the intensive care unit) (binary), Organ donation (i.e. ≥1 solid organ donated for transplantation) (binary)

Source: https://euclinicaltrials.eu/ctis-public/view/2024-517279-20-02